EU clinical trial 2023-508413-16-00: OXYTAHANE - Oxygen therapy: Acute Treatment for paroxysmal dystonic or plegic attacks in alternating hemiplegia of childhood
Protocol code: APHP230673
Sponsor: Assistance Publique Hopitaux De Paris (Hospital/Clinic/Other health care facility). Phase: Therapeutic exploratory (Phase II). Countries: France (ended).
Therapeutic area(s): Diseases [C] - Nervous System Diseases [C10]
Gender: Female, Male. Age: 0-17 years, 18-64 years, 65+ years. Enrolment: 24.
Status: Ended. Start date (EU): 2024-08-07. End date (EU): 2026-03-03. Decision date: 2024-03-27. Results received: No. Last updated: 2025-11-13.

Condition(s): Alternating Hemiplegia of Childhood
Product: Air médical en bouteille, OXYGEN

Primary endpoint: The primary outcome will be the proportion of motor attacks stopped 30 minutes after the beginning of motor symptoms over 5 weeks.

Source: https://euclinicaltrials.eu/ctis-public/view/2023-508413-16-00